EU clinical trial 2023-506832-33-00: Efficacy and Safety of Concizumab prophylaxis in patients with haemophilia A or B with inhibitors
Protocol code: NN7415-4311
Sponsor: Novo Nordisk A/S (Pharmaceutical company). Phase: Therapeutic confirmatory (Phase III). Countries: Denmark (ended), France (ongoing, recruitment ended), Croatia (ongoing, recruitment ended), Poland (ongoing, recruitment ended), Portugal (ongoing, recruitment ended), Italy (ongoing, recruitment ended), Spain (ongoing, recruitment ended), Sweden (ended).
Therapeutic area(s): Diseases [C] - Congenital, Hereditary, and Neonatal Diseases and Abnormalities [C16]
Gender: Male. Age: 0-17 years, 18-64 years, 65+ years. Enrolment: 43.
Start date (EU): 2019-11-06. Decision date: 2024-01-31. Results received: No. Last updated: 2025-09-08.
Decision dates by country: FR: 2024-02-12, ES: 2024-02-01, PT: 2024-01-31, PL: 2024-02-23, SE: 2024-02-05, DK: 2024-01-31, IT: 2024-02-26, HR: 2024-02-02

Condition(s): haemophilia A (HA) with inhibitors and haemophilia B (HB) with inhibitors
Product: Concizumab C 100 mg/mL PDS290, Concizumab C 40 mg/mL PDS290

Primary endpoint: The number of treated spontaneous and traumatic bleeding episodes. On demand (arm 1) From randomisation (week 0) up until start of concizumab treatment (at least 24 weeks) Concizumab (arm 2) From start of the new concizumab dosing regimen (week 0) up until the primary analysis cut-off (at least 32 weeks)
Endpoint(s): Change in SF36v2 bodily pain from start of treatment (week 0) until week 24, Change in SF36v2 physical functioning From start of treatment (week 0) until week 24, Number of treated spontaneous bleeding episodes On demand (arm 1) From randomisation (week 0) up until start of concizumab treatment (at least 24 weeks) Concizumab (arm 2) From start of the new concizumab dosing regimen (week 0) up until the primary analysis cut-off (at least 32 weeks), Number of treated spontaneous and traumatic joint bleeds On demand (arm 1) From randomisation (week 0) up until start of concizumab treatment (at least 24 weeks) Concizumab (arm 2) From start of the new concizumab dosing regimen (week 0) up until the primary analysis cut-off (at least 32 weeks), Number of treated spontaneous and traumatic target joint bleeds On demand (arm 1) From randomisation (week 0) up until start of concizumab treatment (at least 24 weeks) Concizumab (arm 2) From start of the new concizumab dosing regimen (week 0) up until the primary analysis cut-off (at least 32 weeks), Number of thromboembolic events On demand (arm 1 main part) From randomisation to on demand treatment up until start of concizumab treatment Concizumab (arms 2-4) Before the pause: From start of concizumab treatment (week 0) up until 7 weeks after the treatment was paused as well as After the pause: From start of concizumab treatment (week 0) up until the primary analysis cut-off (at least 32 weeks) Concizumab (arm 1 extension part) From start of the new concizumab dosing regimen (visit 9a) up, Number of thromboembolic events Concizumab Before the pause: From start of treatment (week 0) up until 7 weeks after the treatment was paused as well as After the pause: From start of concizumab treatment up until the end of trial (up to 339 weeks), Number of hypersensitivity type reactions On demand (arm 1 main part) From randomisation to on demand treatment up until start of concizumab treatment Concizumab (arms 2-4) Before the pause: From start of concizumab treatment (week 0) up until 7 weeks after the treatment was paused as well as After the pause: From start of concizumab treatment (week 0) up until the primary analysis cut-off (at least 32 weeks) Concizumab (arm 1 extension part) From start of the new concizumab dosing regimen (visi, Number of hypersensitivity type reactions Concizumab Before the pause: From start of treatment (week 0) up until 7 weeks after the treatment was paused as well as After the pause: From start of concizumab treatment up until the end of trial (up to 339 weeks), Number of injection site reactions On demand (arm 1 main part) From randomisation to on demand treatment up until start of concizumab treatment Concizumab (arms 2-4) Before the pause: From start of concizumab treatment (week 0b) up until 7 weeks after the treatment was paused as well as After the pause: From start of concizumab treatment (week 0a) up until the primary analysis cut-off (at least 32 weeks) Concizumab (arm 1 extension part) From start of the new concizumab dosing regimen (visit 9a), Number of injection site reactions Concizumab Before the pause: From start of treatment (week 0) up until 7 weeks after the treatment was paused as well as After the pause: From start of concizumab treatment up until the end of trial (up to 339 weeks), Number of patients with antibodies to concizumab Concizumab (arms 2-4) Before the pause: From start of concizumab treatment (week 0) up until 7 weeks after the treatment was paused as well as After the pause: From start of concizumab treatment (week 0) up until the primary analysis cut-off (at least 32 weeks) Concizumab (arm 1 extension part) From start of the new concizumab dosing regimen (visit 9a) up until the primary analysis cut-off, Number of patients with antibodies to concizumab Concizumab Before the pause: From start of treatment (week 0) up until 7 weeks after the treatment was paused as well as After the pause: From start of concizumab treatment up until the end of trial (339 weeks), Pre-dose (trough) concizumab plasma concentration (Ctrough) Prior to the concizumab administration at week 24 (after restart), Pre-dose thrombin peak Prior to the concizumab administration at week 24 (after restart), Pre-dose free TFPI concentration Prior to the concizumab administration at week 24 (after restart), Maximum concizumab plasma concentration (Cmax) From 0 to 24 hours where 0 is time of the concizumab dose at week 24 (after restart), Area under the concizumab plasma concentration-time curve (AUC) From 0 to 24 hours where 0 is time of the concizumab dose at week 24 (after restart)

Source: https://euclinicaltrials.eu/ctis-public/view/2023-506832-33-00